EU clinical trial 2024-512981-33-00: A Phase 2, Open-Label, Randomized, Master Protocol Study to Evaluate Safety and Efficacy of Multiple Treatment Combinations with Telisotuzumab Adizutecan in Subjects with Metastatic Colorectal Cancer (AndroMETa-CRC-533)
Protocol code: M24-533
Sponsor: AbbVie Deutschland GmbH & Co. KG (Pharmaceutical company). Phase: Therapeutic exploratory (Phase II). Countries: Spain (authorised, recruiting), Greece (ongoing, recruiting), Italy (authorised, recruitment pending), France (ongoing, recruiting), Czechia (ongoing, recruiting), Austria (ongoing, recruiting).
Therapeutic area(s): Diseases [C] - Neoplasms [C04]
Gender: Female, Male. Age: 18-64 years, 65+ years. Enrolment: 104.
Start date (EU): 2025-07-09. Decision date: 2025-06-25. Results received: No. Last updated: 2026-03-11.
Decision dates by country: GR: 2025-06-25, FR: 2025-06-30, AT: 2025-06-29, ES: 2025-06-25, IT: 2025-06-25, CZ: 2025-06-26

Condition(s): Metastatic Colorectal Cancer
Product: FOLINIC ACID, FLUOROURACIL, BEVACIZUMAB, Telisotuzumab adizutecan, FOLINIC ACID, PANITUMUMAB, OXALIPLATIN

Primary endpoint: Substudy 1 and 2: Objective response as assessed by the investigator: confirmed Complete Response (CR) or Partial Response (PR) as assessed by the investigator per RECIST, version 1.1. A repeat assessment must confirm response at least 28 days from the first documented response.
Endpoint(s): Substudy 1 and 2: Progression-Free Survival as assessed by the investigator: PFS is defined as the time from the first dose of study treatment to the first occurrence of radiographic progression based on RECIST version 1.1 as determined by the investigator or death from any cause, whichever occurs earlier., Substudy 1 and 2: DOR as assessed by the investigator: The time from the first documented CR or PR to the first occurrence of radiographic progression per RECIST v1.1 as determined by the investigator or death from any cause, whichever occurs first. DOR is defined for subjects with confirmed CR/PR., Substudy 1 and 2: Overall survival: defined as the time from first dose of study treatment to the event of death from any cause., Substudy 1 and 2: Disease Control as assessed by the investigator: best overall response of confirmed CR or confirmed PR, or Stable Disease (SD) based on RECIST, version 1.1 as determined by the investigator.

Source: https://euclinicaltrials.eu/ctis-public/view/2024-512981-33-00